EU clinical trial 2026-526200-69-00: A Phase IV, Randomized Controlled Trial to Evaluate the Effects of Resistance Training Versus Usual Care on Thigh Muscle Volume During Treatment with the Dual GIP/GLP-1 Receptor Agonist Tirzepatide in Adults with Obesity
Protocol code: RESIST-26-HAL-0150-I
Sponsor: Klinikum der Technischen Universitaet Muenchen (TUM Klinikum) (Hospital/Clinic/Other health care facility). Phase: Therapeutic use (Phase IV). Countries: Germany (authorised, recruitment pending).
Therapeutic area(s): Diseases [C] - Nutritional and Metabolic Diseases [C18]
Gender: Female, Male. Age: 18-64 years. Enrolment: 150.
Status: Authorised, recruitment pending. Decision date: 2026-08-04. Results received: No. Last updated: 2026-08-04.

Condition(s): Obesity
Product: Mounjaro 2.5 mg/dose KwikPen solution for injection in pre-filled pen, Mounjaro 5 mg/dose KwikPen solution for injection in pre-filled pen, Mounjaro 10 mg/dose KwikPen solution for injection in pre-filled pen, Mounjaro 7.5 mg/dose KwikPen solution for injection in pre-filled pen

Primary endpoint: Change in contractile thigh muscle volume (mL), as assessed by magnetic resonance imaging (MRI)
Endpoint(s): Change in body weight (kg), as assessed by a calibrated scale, Change in anterior thigh intramuscular fat fraction (%), as assessed by MRI, Change in contractile muscle volume of the combined scapular and upper back musculature (mL), as assessed by MRI, Change in combined whole-trunk and thigh fat volume (mL), as assessed by MRI, Change in peak isometric knee extension torque (Nm), as assessed using an isokinetic dynamometer, Change in maximum handgrip strength (kg), as assessed by a hand dynamometer, Change in the number of chair stands, as assessed by the 30-second chair stand test, Change in usual gait speed (m/s), as assessed by the time required to walk 10 meters, Change in physical health-related QoL, as assessed by the Physical Component Summary score of the Short-Form-36 Health Survey, Version 2, Acute Form (SF-36v2), Change in mental health-related QoL, as assessed by the Mental Component Summary score of the SF-36v2, Change in obesity-specific QoL, as assessed by the Total Score of the Impact of Weight on Quality of Life-Lite Clinical Trials Version (IWQOL-Lite-CT), Change in depressive symptoms, as assessed by the Patient Health Questionnaire-9 (PHQ-9), Change in daily moderate-to-vigorous physical activity (MVPA; min/day), as assessed by ActiGraph accelerometry, Change in skeletal muscle mass (kg), as assessed by bioelectrical impedance analysis (BIA), Change in fat mass (kg), as assessed by BIA, Change in phase angle (°), as assessed by BIA, Change in absolute maximal oxygen consumption (mL/min), as assessed by cardiopulmonary exercise testing (CPET), Change in relative maximal oxygen consumption (mL/kg/min), as assessed by CPET, Adherence to the IMP, defined as the proportion of prescribed doses administered during the treatment period (%), assessed by injection pen counts, Highest achieved and maintained (tolerated) dose of tirzepatide during the intervention period, defined as the highest weekly dose level maintained for ≥4 weeks, allowing up to one missed scheduled administration, without subsequent dose reduction and without permanent discontinuation due to intolerance, Adherence to the resistance training intervention (experimental group only), defined as the mean number of completed training sessions per week during the intervention period, assessed using automatically recorded training data from the exercise devices

Source: https://euclinicaltrials.eu/ctis-public/view/2026-526200-69-00